EU clinical trial 2023-507142-83-00: A Phase 3 Randomized, Open-Label Study to Assess the Efficacy, Safety, and Pharmacokinetics of Golimumab Treatment, a Human anti-TNFα Monoclonal Antibody, Administered Subcutaneously in Pediatric Participants with Moderately to Severely Active Ulcerative Colitis
Protocol code: CNTO148UCO3003
Sponsor: Janssen - Cilag International, Janssen Biologics B.V. (Pharmaceutical company). Phase: Therapeutic confirmatory (Phase III). Countries: Poland (ended), France (ended), Italy (ended).
Therapeutic area(s): Diseases [C] - Digestive System Diseases [C06]
Gender: Female, Male. Age: 0-17 years. Enrolment: 7.
Status: Ended. Start date (EU): 2019-01-09. End date (EU): 2025-02-13. Decision date: 2024-07-31. Results received: No. Last updated: 2024-11-24.
Decision dates by country: FR: 2024-07-31, IT: 2024-08-12, PL: 2024-08-04

Condition(s): Ulcerative Colitis
Product: Simponi 50 mg solution for injection in pre-filled syringe., Simponi 45 mg/0.45 mL solution for injection in pre-filled pen., Simponi 100 mg solution for injection in pre-filled syringe.

Primary endpoint: Clinical remission as assessed by the Mayo score.
Endpoint(s): 1. Clinical response as assessed by the Mayo score., 2. Clinical remission as assessed by the PUCAI score., 3. Endoscopic healing., 4. Clinical remission as assessed by the PUCAI score., 5. Endoscopic healing., 6. Rémission symtomatologique., 7. Clinical remission as assessed by the Mayo score.

Source: https://euclinicaltrials.eu/ctis-public/view/2023-507142-83-00